EU clinical trial 2023-509208-14-00: C1071005 - MAGNETISMM-5: AN OPEN-LABEL, 3-ARM, MULTICENTER, RANDOMIZED PHASE 3 STUDY TO EVALUATE THE EFFICACY AND SAFETY OF ELRANATAMAB (PF-06863135) MONOTHERAPY AND ELRANATAMAB + DARATUMUMAB VERSUS DARATUMUMAB + POMALIDOMIDE + DEXAMETHASONE IN PARTICIPANTS WITH RELAPSED/REFRACTORY MULTIPLE MYELOMA WHO HAVE RECEIVED AT LEAST 1 PRIOR LINE OF THERAPY INCLUDING LENALIDOMIDE AND A PROTEASOME INHIBITOR
Protocol code: C1071005
Sponsor: Pfizer Inc. (Pharmaceutical company). Phase: Therapeutic confirmatory (Phase III). Countries: Czechia (ongoing, recruitment ended), Italy (ongoing, recruitment ended), Spain (ongoing, recruitment ended), Sweden (ongoing, recruitment ended), Finland (ongoing, recruitment ended), Norway (ongoing, recruitment ended), Austria (ongoing, recruitment ended), Germany (ongoing, recruitment ended), France (ongoing, recruitment ended), Belgium (ongoing, recruitment ended), Netherlands (ongoing, recruitment ended), Poland (ongoing, recruitment ended), Greece (ongoing, recruitment ended).
Therapeutic area(s): Diseases [C] - Neoplasms [C04]
Gender: Female, Male. Age: 18-64 years, 65+ years. Enrolment: 361.
Status: Ongoing, recruitment ended. Start date (EU): 2021-09-28. Decision date: 2024-09-05. Results received: No. Last updated: 2026-08-03.
Decision dates by country: DE: 2024-09-23, GR: 2024-11-26, PL: 2024-10-09, CZ: 2024-09-09, FI: 2024-09-05, SE: 2024-09-05, FR: 2024-09-06, AT: 2024-09-08, ES: 2024-09-09, NO: 2024-09-05, BE: 2024-09-09, NL: 2024-09-05, IT: 2024-09-23

Condition(s): MULTIPLE MYELOMA
Product: Imnovid 1 mg hard capsules, ELRANATAMAB, Imnovid 3 mg hard capsules, Neofordex 40 mg tablets, DARZALEX 1800 mg solution for injection, Imnovid 4 mg hard capsules, Privigen 100 mg/ml solution for infusion, Imnovid 2 mg hard capsules

Primary endpoint: Part 1: DLTs during the DLT observation period (14 days from first elranatamab dose + first 28 days following first dose of elranatamab + daratumumab)., Part 2: PFS by blinded independent central review (BICR) per IMWG, Part 3: AEs as characterized by type, frequency, severity (as graded by NCI CTCAE v5.0), timing, and seriousness, and relationship to study treatment during the first 84 days following first elranatamab dose. Severity of CRS and ICANS will be assessed according to ASTCT criteria
Endpoint(s): Part 1: Grade ≥2 CRS rate during the 28 days following the first dose of elranatamab., Part 1: Adverse events (AEs) as characterized by type, frequency, severity (as graded by NCI CTCAE v5.0), timing, seriousness, and relationship to elranatamab in combination with daratumumab. Severity of CRS and immune effector cell-associated neurotoxicity syndrome (ICANS) will be assessed according to ASTCT criteria; •Laboratory abnormalities as characterized by type, frequency, severity (as graded by NCI CTCAE v5.0), and timing., Part1: ORR and CRR, per IMWG (International Myeloma Working Group) response criteria as determined by investigator; • Time to event endpoints: TTR, DOR, DOCR and PFS per IMWG response criteria as determined by investigator, and OS; • MRD negativity rate (central lab) per IMWG sequencing criteria., Part 1: Predose and postdose concentrations of elranatamab, Part 1: Anti-drug antibodies (ADAs) and neutralizing antibodies (NAbs) against elranatamab., Part 1: Predose concentrations of daratumumab., Part 2 Key secondary: OS., Part 2: •PFS and PFS2 by Investigator per IMWG •ORR by BICR per IMWG •DOR by BICR per IMWG •CRR by BICR per IMWG •DOCR by BICR per IMWG •TTR by BICR per IMWG •MRD negativity rate (central lab) per IMWG •Sustained MRD negativity rate (central lab) per IMWG, Part 2: • AEs as characterized by type, frequency, severity (as graded by NCI CTCAE v5.0), timing, seriousness, and relationship to study treatment. The severity of CRS and ICANS will be assessed according to ASTCT criteria. • Laboratory abnormalities as characterized by type, frequency, severity (as graded by NCI CTCAE v5.0), and timing., Part 2: Predose and postdose concentrations of elranatamab., Part 2: ADAs and NAbs against elranatamab., Part 2: of Cancer Quality of Life Questionnaire – Core 30 (EORTC QLQ-C30) and myeloma quality of life questionnaire (MY20)., Part 3: • AEs as characterized by type, frequency, severity (as graded by NCI CTCAE v5.0), timing, seriousness, and relationship to study treatment. Severity of CRS and ICANS will be assessed according to ASTCT criteria • Laboratory abnormalities as characterized by type, frequency, severity (as graded by NCI CTCAE v5.0), and timing, Part 3: • ORR and CRR per IMWG • Time to event endpoints: TTR, DOR, DOCR and PFS per IMWG response criteria, and OS • MRD negativity rate (central lab) per IMWG • Sustained MRD negativity rate (central lab) per IMWG, Part 3: Predose and postdose concentrations of elranatamab, Part 3: ADAs and NAbs against elranatamab, Part 3: Predose concentrations of daratumumab

Source: https://euclinicaltrials.eu/ctis-public/view/2023-509208-14-00